EU clinical trial 2024-514904-14-00: Acsé Vemurafenib : Secured access to vemurafenib for patients with tumors harboring BRAF genomic alterations
Protocol code: UC-0105/1401
Sponsor: Unicancer (Hospital/Clinic/Other health care facility). Phase: Therapeutic exploratory (Phase II). Countries: France (ongoing, recruitment ended).
Therapeutic area(s): Diseases [C] - Neoplasms [C04]
Gender: Female, Male. Age: 18-64 years, 65+ years. Enrolment: 50.
Status: Ongoing, recruitment ended. Start date (EU): 2014-10-08. Decision date: 2024-07-16. Results received: No. Last updated: 2024-07-16.

Condition(s): Patients with metastatic or unresectable locally advanced malignancies harboring BRAF genomic alterations, the biological target of vemurafenib, and who are no more amenable to curative treatment
Product: Zelboraf 240 mg film-coated tablets

Primary endpoint: Anti-tumor activity of vemurafenib in each cohort, as the primary objective of the trial, will be carried out by the determination of the confirmed objective response/remission rate (complete or partial response/remission) according to RECIST criteria v1.1 for solid tumors (appendix 8), IMWG Response Criteria for myeloma (appendix 9), and IWCLL for CLL
Endpoint(s): Disease control rate, Response duration, Progression-free survival, Overall Survival, Safety (CTCAE v4.0), Correlative research endpoints.

Source: https://euclinicaltrials.eu/ctis-public/view/2024-514904-14-00